EU clinical trial 2026-525248-13-00: A Multicenter, Multi-Part, Phase 1/2 Study of EIK1005 as Monotherapy and in Combination with Pembrolizumab in Participants with Advanced Solid Tumors, including Checkpoint Inhibitor Naïve Participants with Microsatellite Instability High (MSI-H) or Mismatch Repair Deficient (dMMR) Tumors
Protocol code: EIK1005-002
Sponsor: Eikon Therapeutics Inc. (Pharmaceutical company). Phase: Phase I and Phase II (Integrated)- Other. Countries: France (authorised, recruitment pending), Spain (authorised, recruiting), Norway (authorised, recruiting), Italy (authorised, recruiting), Germany (authorised, recruiting), Austria (authorised, recruiting), Poland (authorised, recruiting), Finland (authorised, recruiting), Portugal (authorised, recruitment pending).
Therapeutic area(s): Diseases [C] - Neoplasms [C04]
Gender: Female, Male. Age: 18-64 years, 65+ years. Enrolment: 63.
Start date (EU): 2026-07-07. Decision date: 2026-05-15. Results received: No. Last updated: 2026-07-24.
Decision dates by country: NO: 2026-05-15, PT: 2026-07-15, IT: 2026-05-18, FR: 2026-05-18, AT: 2026-05-17, ES: 2026-05-22, PL: 2026-05-25, DE: 2026-05-19, FI: 2026-05-20

Condition(s): Advanced Solid Tumors
Product: EIK1005 10mg Tablets, PEMBROLIZUMAB, EIK1005 200mg Tablets, EIK1005 50mg Tablets

Primary endpoint: 1. DLTs & AEs, 2. AEs
Endpoint(s): 1. OR (defined as participants who have a CR or PR) by RECIST 1.1 as assessed by the Investigator., 2. DOR (defined as the time from the first documented evidence of CR or PR until disease progression or death due to any cause, whichever occurs first, in participants demonstrating CR or PR) by RECIST 1.1 as assessed by the Investigator., 3. DC (defined as participants with a BOR of CR, PR, or SD) by RECIST 1.1 as assessed by the Investigator., 4. OR, 5. DOR, 6. DC, 7. PFS (defined as the time from randomization to the first documented disease progression by RECIST 1.1 as assessed by the Investigator or death due to any cause, whichever occurs first)., 8. PK parameters derived from plasma concentrations of EIK1005, following multiple doses, including but not limited to: • AUC0-24, AUCtau,ss, Cmax, t1/2, tmax, Rac-Cmax, RacAUC

Source: https://euclinicaltrials.eu/ctis-public/view/2026-525248-13-00